EU clinical trial 2024-515566-13-00: A Randomized, Open-Label, Multicenter, Phase 3 Study of Zilovertamab Vedotin (MK-2140) in Combination With R-CHP Versus R-CHOP in Participants With Previously Untreated Diffuse Large B-Cell Lymphoma (DLBCL) (waveLINE-010)
Protocol code: MK-2140-010
Sponsor: Merck Sharp & Dohme LLC (Pharmaceutical company). Phase: Therapeutic confirmatory (Phase III). Countries: Spain (ongoing, recruiting), Portugal (ongoing, recruiting), Netherlands (ongoing, recruiting), Hungary (ongoing, recruiting), Greece (ongoing, recruiting), Denmark (ongoing, recruiting), France (ongoing, recruiting), Italy (ongoing, recruiting), Poland (ongoing, recruiting), Belgium (ongoing, recruiting), Romania (ongoing, recruiting).
Therapeutic area(s): Diseases [C] - Neoplasms [C04]
Gender: Female, Male. Age: 18-64 years, 65+ years. Enrolment: 282.
Status: Ongoing, recruiting. Start date (EU): 2025-03-19. Decision date: 2025-02-11. Results received: No. Last updated: 2026-08-03.
Decision dates by country: IT: 2025-02-14, FR: 2025-02-17, RO: 2025-02-14, HU: 2025-02-14, PL: 2025-02-17, NL: 2025-02-14, ES: 2025-02-11, BE: 2025-02-11, PT: 2025-02-13, GR: 2025-02-11, DK: 2025-02-11

Condition(s): Diffuse Large B-Cell Lymphoma (DLBCL)
Product: METHYLPREDNISOLONE, PREDNISOLONE, VINCRISTINE, CYCLOPHOSPHAMIDE, RITUXIMAB, DOXORUBICIN, Zilovertamab vedotin, PREDNISONE

Primary endpoint: Progression-free Survival (PFS) per Lugano Response Criteria
Endpoint(s): Complete Response (CR) at End of Treatment (EOT) per Lugano Response Criteria, Overall Survival (OS), Event-free Survival (EFS) per Lugano Response Criteria, Duration of CR, Number of Participants Who Experienced At Least One Adverse Event (AE), Number of Participants Who Discontinued Study Treatment Due to an Adverse Event (AE), Change From Baseline in Health-Related Quality Of Life (HRQoL) on Functional Assessment of Cancer Therapy Lymphoma (FACT-Lym) Trial Outcome Index (TOI) Score, Change From Baseline in HRQoL on FACT-Lym Total Score, Change From Baseline in HRQoL on FACT-Lym Physical Wellbeing (PWB) score, Change From Baseline in HRQoL on Functional Assessment of Cancer Therapy/Gynecologic Oncology Group-Neurotoxicity (FACT/GOG-NTX) Neurotoxicity Subscale Score

Source: https://euclinicaltrials.eu/ctis-public/view/2024-515566-13-00